EU clinical trial 2025-521770-34-00: Nebulised lIposomal aMphotericin B in chronic pUlmonary aSpergillosis: a deposition study
Sponsor: Radboud universitair medisch centrum Stichting (Hospital/Clinic/Other health care facility). Phase: Human Pharmacology (Phase I)- Other. Countries: Netherlands (authorised, recruitment pending).
Therapeutic area(s): Diseases [C] - Bacterial Infections and Mycoses [C01]; Analytical, Diagnostic and Therapeutic Techniques and Equipment [E] - Therapeutics [E02]; Diseases [C] - Respiratory Tract Diseases [C08]
Gender: Female, Male. Age: 18-64 years, 65+ years. Enrolment: 18.
Status: Authorised, recruitment pending. Decision date: 2025-09-04. Results received: No. Last updated: 2025-09-04.

Condition(s): Chronic pulmonary aspergillosis
Product: AmBisome liposomale amfotericine B 50 mg, poeder voor oplossing voor infusie, TECHNETIUM (99MTC) PERTECHNETATE

Primary endpoint: The amount of AmBisome deposited in the lungs measured through single-photon emission computed tomography (SPECT/CT)., The amount of AmBisome in the lungs compared to the blood concentrations to understand drug absorption and distribution, The most appropriate dose of nebulised AmBisome based on pulmonary deposition and pharmacokinetics.
Endpoint(s): A validated GMP-grade procedure for Technetium-99m labelled AmBisome., Number of adverse reactions associated with nebulised AmBisome, including respiratory symptoms, effects on pulmonary function and (S)AEs., Assessment of PROs using a validated PRO instruments (TSQM) to assess side effects, treatment convenience and global satisfaction with therapy.

Source: https://euclinicaltrials.eu/ctis-public/view/2025-521770-34-00